EU clinical trial 2024-515023-11-00: Randomized, Double-Blind, Active-Control, Multicenter Phase 3 Trial of Casdatifan and Cabozantinib Versus Placebo and Cabozantinib in Patients With Advanced Clear Cell Renal Cell Carcinoma
Protocol code: PEAK-1
Sponsor: Arcus Biosciences Inc. (Pharmaceutical company). Phase: Therapeutic confirmatory (Phase III). Countries: Italy (ongoing, recruiting), Spain (ongoing, recruiting), Romania (ongoing, recruiting), Germany (ongoing, recruiting), Netherlands (ongoing, recruiting), Poland (ongoing, recruiting), France (ongoing, recruiting), Czechia (ongoing, recruiting).
Therapeutic area(s): Diseases [C] - Neoplasms [C04]
Gender: Female, Male. Age: 18-64 years, 65+ years. Enrolment: 326.
Status: Ongoing, recruiting. Start date (EU): 2026-01-22. Decision date: 2025-11-24. Results received: No. Last updated: 2026-07-30.
Decision dates by country: PL: 2025-11-30, IT: 2025-11-25, ES: 2025-11-24, RO: 2025-11-26, NL: 2025-11-26, CZ: 2025-11-25, FR: 2025-11-26, DE: 2025-11-25

Condition(s): Advanced Clear Cell Renal Cell Carcinoma, Metastatic Clear Cell Renal Cell Carcinoma
Product: CASDATIFAN, PLACEBO, CABOZANTINIB, CABOZANTINIB, CABOZANTINIB

Primary endpoint: PFS is defined as the time from date of randomization until progressive disease or death from any cause, whichever comes first, as assessed by BICR according to RECIST 1.1.
Endpoint(s): OS is defined as the time from date of randomization until the date of death from any cause., ORR is defined as the proportion of patients who have achieved confirmed complete response (CR) or confirmed partial response (PR) to study therapy, as assessed by BICR according to RECIST 1.1., Duration of response is measured from the time of first response (CR or PR) until the date of first documented progressive disease or death, whichever comes first, as assessed by BICR according to RECIST 1.1., Disease control rate (DCR) is defined as the proportion of patients who have achieved confirmed CR, confirmed PR, or stable disease for ≥ 16 weeks from date of randomization, as assessed by BICR according to RECIST 1.1., The incidence and severity of treatment-emergent adverse events and treatment-emergent serious adverse events, and any clinically meaningful trends in safety parameters., Time to first symptom deterioration in National Comprehensive Cancer Network/Functional Assessment of Cancer Therapy-Kidney Symptom Index – Disease Related Symptoms (NFKSI-DRS) Items 1-9 sub-scale score.

Source: https://euclinicaltrials.eu/ctis-public/view/2024-515023-11-00